EU clinical trial 2025-524057-13-00: AchilleS tendinoPathy treated with cortIcosteRoid injEctions.
Protocol code: ASPIRE trial
Sponsor: Erasmus Universitair Medisch Centrum Rotterdam (Erasmus MC) (Hospital/Clinic/Other health care facility). Phase: Therapeutic confirmatory (Phase III). Countries: Netherlands (ongoing, recruiting).
Therapeutic area(s): Diseases [C] - Musculoskeletal Diseases [C05]; Analytical, Diagnostic and Therapeutic Techniques and Equipment [E] - Therapeutics [E02]
Gender: Female, Male. Age: 18-64 years. Enrolment: 276.
Status: Ongoing, recruiting. Start date (EU): 2026-06-03. Decision date: 2026-03-16. Results received: No. Last updated: 2026-05-28.
Decision dates by country: NL: 2026-05-28

Condition(s): Achilles tendinopathy

Source: https://euclinicaltrials.eu/ctis-public/view/2025-524057-13-00